EU clinical trial 2024-516167-86-00: LEONARD.LEvOsimendaN vs. Placebo Before Tricuspid VAlve Surgery in Patients with Right Ventricular Dysfunction (LEONARD)
Protocol code: APHP200072
Sponsor: Assistance Publique Hopitaux De Paris (Hospital/Clinic/Other health care facility). Phase: Therapeutic confirmatory (Phase III). Countries: France (authorised, recruitment pending).
Therapeutic area(s): Diseases [C] - Cardiovascular Diseases [C14]
Gender: Female, Male. Age: 18-64 years, 65+ years. Enrolment: 230.
Status: Authorised, recruitment pending. Decision date: 2024-12-03. Results received: No. Last updated: 2026-02-22.

Condition(s): Patients referred for an isolated or a combined surgical correction of functional moderate to severe tricuspid regurgitation
Product: Placebo of ZIMINO (glucose 5%), ZIMINO 2,5 mg/ml, solution à diluer pour perfusion

Primary endpoint: The primary end point is a composite element reflecting low cardiac output syndrome at 90 days: - 1) Catecholamine infusion persisting beyond 48 hours after cardiac surgery, - 2) Need for circulatory mechanical assist devices in the postoperative period, - 3) Need for renal replacement therapy at any time during intensive care unit stay.
Endpoint(s): 1) Mortality at day 90, 2) Each component of the primary end point, 3) The study drug safety was assessed by recording of the incidence refractory hypotension was defined as a failure to increase mean arterial pressure above 60 mmHg despite optimal management.

Source: https://euclinicaltrials.eu/ctis-public/view/2024-516167-86-00